EU clinical trial 2023-503383-17-01: International Phase III, Multi-center, Randomized, Double-blind, Placebo and Active-controlled and Parallel group Clinical Trial to Evaluate the Efficacy and Safety of Oral Minoxidil 1 mg in Female patients with Androgenetic Alopecia.
Protocol code: P22112a
Sponsor: Industrial Farmaceutica Cantabria S.A. (Pharmaceutical company). Phase: Therapeutic confirmatory (Phase III). Countries: Portugal (ongoing, recruitment ended), Spain (ended), Germany (ongoing, recruitment ended), Italy (ended).
Therapeutic area(s): Diseases [C] - Skin and Connective Tissue Diseases [C17]; Diseases [C] - Hormonal diseases [C19]
Gender: Female. Age: 18-64 years, 65+ years. Enrolment: 459.
Start date (EU): 2024-10-10. Decision date: 2024-01-22. Results received: No. Last updated: 2026-07-06.
Decision dates by country: IT: 2024-05-10, PT: 2024-01-25, DE: 2024-01-23, ES: 2024-01-22

Condition(s): Female androgenetic alopecia
Product: Placebo to Minoxidil 1 mg tablet, Minoxidil 1 mg tablet, Placebo to Regaxidil 20 mg/ml solution, Regaxidil 20 mg/ml solución cutánea

Primary endpoint: The main (primary) efficacy endpoint is the change from Baseline in TAHC at Week 24 (6 months)
Endpoint(s): Secondary efficacy endpoints: Change from Baseline in TAHC at Week 12, Secondary efficacy endpoints: Changes from Baseline in Target Area non vellus Hair Width (TAHW) at Weeks 12 and 24, Secondary efficacy endpoints: Changes from Baseline in Target Area non vellus Hair Density (TAHD) at Weeks 12 and 24, Secondary efficacy endpoints: Investigator's Global Assessment (IGA) at Weeks 12 and 24, Secondary efficacy endpoints: Women’s Androgenetic Alopecia Quality of Life (WAA-QoL) at Weeks 12 and 24, Secondary safety endpoints: Overall number of treatment emergent adverse events (TEAEs) (including serious TEAEs) up to the end of the clinical trial (Visit 7/Week 28), Secondary safety endpoints: Change from Baseline in safety laboratory parameters (hematology, clinical chemistry, and urinalysis) to Visit 4/Week 12 and Visit 6/Week 24, Secondary safety endpoints: Change from Baseline in vital signs (blood pressure, pulse rate, body temperature) to Visit 4/Week 12, Visit 6/Week 24, and Visit 7/Week 28, Secondary safety endpoints: Evaluation of 12-lead electrocardiogram (ECG) to Visit 4/Week 12, Visit 6/Week 24, and Visit 7/Week 28, Secondary safety endpoints: Evaluation of physical examination to Visit 4/Week 12, Visit 6/Week 24, and Visit 7/Week 28, Secondary safety endpoints: Evaluation of hypertrichosis to Visit 4/Week 12, Visit 6/Week 24, and Visit 7/Week 28

Source: https://euclinicaltrials.eu/ctis-public/view/2023-503383-17-01